EU clinical trial 2023-508508-39-01: A multi-center single arm Phase II study to evaluate the safety and efficacy of genetically engineered autologous cells expressing anti-CD20 and anti-CD19 specific chimeric antigen receptor in subjects with relapsed and/or refractory diffuse large B cell lymphoma
Protocol code: M-2018-344
Sponsor: Miltenyi Biomedicine GmbH (Pharmaceutical company). Phase: Therapeutic exploratory (Phase II). Countries: Hungary (ended), Croatia (ended).
Therapeutic area(s): Diseases [C] - Neoplasms [C04]
Gender: Female, Male. Age: 18-64 years, 65+ years. Enrolment: 4.
Status: Ended. End date (EU): 2026-07-14. Decision date: 2024-06-21. Results received: No. Last updated: 2026-05-06.
Decision dates by country: HU: 2024-06-21, HR: 2024-07-01

Condition(s): Relapsed/refractory diffuse large B cell lymphoma (R-R DLBCL)
Product: SULFAMETHOXAZOLE AND TRIMETHOPRIM, ACALABRUTINIB, ALLOPURINOL, BENDAMUSTINE, LEVETIRACETAM, FILGRASTIM, CYCLOPHOSPHAMIDE, MB-CART2019.1, TOCILIZUMAB, PARACETAMOL, FLUDARABINE, DIPHENHYDRAMINE

Primary endpoint: Objective Response Rate (ORR) defined as the proportion of subjects with partial response (PR) or complete response (CR) as their best overall response as assessed using Lugano Criteria (Cheson et al., 2014) as determined by an IRC
Endpoint(s): • Complete response rate (CRR) using Lugano 2014 Criteria (Cheson et al, 2014)* at 1 and 6 months • Duration of Response (DOR) • ORR using Lugano 2014 criteria (Cheson et al, 2014)* at 1 and 6 month • Best Overall Response (BOR) • Progression-Free Survival (PFS) • Overall Survival (OS) • Type, frequency and severity of adverse events (AEs), serious adverse events (SAEs) and adverse events of special interest (AESI), Continued translation, • Incidence of anti-MB-CART2019.1 antibodies • Phenotype and persistence of MB-CART2019.1 • Measure and correlate the types and level of cytokines in subjects following MB-CART2019.1 infusion with severity of CRS, ICANS, and efficacy • Correlate the changes in tumor CD19 and CD20 antigen expression with disease progression and relapse • Quality of Life (QoL)/Patient-Reported Outcome (PRO) assessments (EQ-5D-5L and FACT-Lym)

Source: https://euclinicaltrials.eu/ctis-public/view/2023-508508-39-01